EU clinical trial 2023-509767-25-00: Phase 1 Study of IMC-P115C in Advanced PRAME Positive Cancers
Protocol code: IMC-P115C-1005
Sponsor: Immunocore Limited (Pharmaceutical company). Phase: Human Pharmacology (Phase I)- First administration to humans. Countries: Italy (ongoing, recruiting), Spain (ongoing, recruiting), France (ongoing, recruiting).
Therapeutic area(s): Diseases [C] - Neoplasms [C04]
Gender: Female, Male. Age: 18-64 years, 65+ years. Enrolment: 520.
Status: Ongoing, recruiting. Start date (EU): 2024-11-07. Decision date: 2024-09-12. Results received: No. Last updated: 2026-07-27.
Decision dates by country: IT: 2024-09-16, FR: 2024-09-12, ES: 2024-09-17

Condition(s): Advanced PRAME Positive Cancers

Source: https://euclinicaltrials.eu/ctis-public/view/2023-509767-25-00